EU clinical trial 2022-502624-44-00: Prospective, multicenter, randomized, open-label, parallel-group controlled phase 3 study of tacrolimus minimization in kidney transplant recipients selected according to the AGORA algorithm for their low immunological risk and medium-term graft failure
Protocol code: RC22-0525
Sponsor: Centre Hospitalier Universitaire De Nantes (Hospital/Clinic/Other health care facility). Phase: Therapeutic confirmatory (Phase III). Countries: Spain (ongoing, recruiting), France (ongoing, recruiting), Norway (ongoing, recruiting).
Therapeutic area(s): Not possible to specify
Gender: Female, Male. Age: 18-64 years, 65+ years. Enrolment: 343.
Status: Ongoing, recruiting. Start date (EU): 2024-12-10. Decision date: 2023-12-22. Results received: No. Last updated: 2026-02-18.
Decision dates by country: ES: 2024-01-09, FR: 2024-01-09, NO: 2023-12-22

Condition(s): kidney transplantation
Product: PROGRAF 0,5 mg capsule, CellCept 500 mg film-coated tablets, SOLUPRED 5 mg, comprimé orodispersible, CORTANCYL 1 mg, comprimé, Advagraf 0.5 mg prolonged-release hard capsules, Omnipaque 300 mg I/ml solution injectable, Myfortic 180 mg comprimés gastro-résistants

Primary endpoint: The primary endpoint of the AGORAC Trial will be the improvement of the renal function (mGFR) at 18 months after “ultra” minimization of Tacrolimus (TAC: Prograf®, Advagraf®) as assessed by iohexol clearance3
Endpoint(s): Compare between the two treatment arms at the end of the 18-month follow-up, the incidence of Biopsy proven rejection (BPAR) according to the 2017 Banff classification (including borderline lesions)31, Compare between the two treatment arms at the end of the 18-month follow-up the type, severity and treatment of BPAR, Compare between the two treatment arms at the end of the 18-month follow-up the Appearance of de novo DSA (4 digits and MFI threshold >500), Compare between the two treatment arms at the end of the 18-month follow-up the appearance or worsening of histological lesions of interstitial fibrosis and inflammatory tubular atrophy (at indication biopsy or the end of the study) of study biopsy by considering that only patients with normal histology or with an IFTA-1 or 2 will be randomized, Compare between the two treatment arms at the end of the 18-month follow-up the prevalence of death, and graft loss at end of study, Compare between the two treatment arms at the end of the 18-month follow-up the Prevalence of metabolic disorders: post-transplant diabetes mellitus (PTDM), dyslipidaemia and hypertension at end of study, Compare between the two treatment arms at the end of the 18 months follow up the treatment adherence consisting in monitoring immunosuppression adherence using Trackyourmed® to monitor individual variability tacrolimus intake, Compare between the two treatment arms at the end of the 18 months follow up the change in quality of life estimated using the EQ-5D questionnaire fulfilled by patients at baseline, M3, M6, M9, M12, M15 and M18, Estimated Glomerular Filtartion rate (eGFR) will be calculated at 12 months by CKD-EPI, compared between the two treatment arms at the end of the 18-month follow-up: 9. Composite endpoint : incidence of either secondary endpoint #1 or #3 or #4 or #5 or #6.

Source: https://euclinicaltrials.eu/ctis-public/view/2022-502624-44-00